EU clinical trial 2024-517107-37-00: Study to compare drug availability in bloodstream of two oral formulations of mesalazine in healthy volunteers under fed conditions.
Protocol code: CLEU-0524/FED
Sponsor: Faes Farma S.A. (Pharmaceutical company). Phase: Human Pharmacology (Phase I)- Other. Countries: Spain (ended).
Therapeutic area(s): Diseases [C] - Digestive System Diseases [C06]
Gender: Female, Male. Age: 18-64 years. Enrolment: 60.
Status: Ended. Start date (EU): 2024-12-20. End date (EU): 2025-02-21. Decision date: 2024-11-11. Results received: No. Last updated: 2025-03-07.
Decision dates by country: ES: 2024-12-16

Condition(s): Chronic idiopathic inflammatory bowel disease

Source: https://euclinicaltrials.eu/ctis-public/view/2024-517107-37-00